EU clinical trial 2024-511111-13-01: GOut TrEatment STrategy (GO TEST) FINALE study, a multicentre pragmatic randomized superiority trial of continuation versus cessation of urate lowering therapies in gout in remission.
Sponsor: Sint Maartenskliniek (Hospital/Clinic/Other health care facility). Phase: Therapeutic use (Phase IV). Countries: Netherlands (ended).
Therapeutic area(s): Diseases [C] - Musculoskeletal Diseases [C05]
Gender: Female, Male. Age: 18-64 years. Enrolment: 310.
Status: Ended. Start date (EU): 2024-07-09. End date (EU): 2025-06-16. Decision date: 2024-07-09. Results received: Yes. Last updated: 2024-07-09.

Condition(s): Gout
Product: ALLOPURINOL, BENZBROMARONE, FEBUXOSTAT

Primary endpoint: The between group difference in proportion of patients fulfilling the adapted preliminary gout remission criteria during the last 6 months of 24 month follow up using superiority testing. If superiority is not shown, non-inferiority testing with a prespecified NI margin of 0.08 will be performed exploratory as secondary outcome.

Source: https://euclinicaltrials.eu/ctis-public/view/2024-511111-13-01